EU clinical trial 2025-523641-10-00: PHARMACOKINETICS OF PETRELINTIDE FOLLOWING ADMINISTRATION TO PARTICIPANTS WITH IMPAIRED HEPATIC FUNCTION
Protocol code: ZP8396-25077
Sponsor: Zealand Pharma A/S (Pharmaceutical company). Phase: Human Pharmacology (Phase I)- Other. Countries: Slovakia (ongoing, recruiting), Poland (ongoing, recruiting).
Therapeutic area(s): Not possible to specify
Gender: Female, Male. Age: 18-64 years, 65+ years. Enrolment: 36.
Status: Ongoing, recruiting. Start date (EU): 2026-05-18. Decision date: 2026-05-06. Results received: No. Last updated: 2026-05-13.
Decision dates by country: PL: 2026-05-07, SK: 2026-05-06

Condition(s): Healthy / hepatic impaired volunteers only study to assess PK parameters

Source: https://euclinicaltrials.eu/ctis-public/view/2025-523641-10-00